EU clinical trial 2024-514775-17-00: A prospective, multicenter phase II trial investigating Gemcitabine/Oxaliplatin/Rituximab with Tafasitamab (MOR208) for patients with relapsed/refractory transformed or Aggressive Lymphoma (GOAL II)
Protocol code: 19-00153
Sponsor: Universitaetsmedizin der Johannes Gutenberg-Universitaet Mainz KöR (Hospital/Clinic/Other health care facility). Phase: Therapeutic exploratory (Phase II). Countries: Germany (ended).
Therapeutic area(s): Diseases [C] - Neoplasms [C04]
Gender: Female, Male. Age: 18-64 years, 65+ years. Enrolment: 64.
Status: Ended. Start date (EU): 2021-02-10. End date (EU): 2026-06-25. Decision date: 2024-08-22. Results received: No. Last updated: 2024-08-22.

Condition(s): Malignant B-cell lymphoma
Product: RITUXIMAB, OXALIPLATIN, GEMCITABINE, MINJUVI 200 mg powder for concentrate for solution for infusion

Primary endpoint: ORR of the regimen within the first 8 treatment cycles
Endpoint(s): ORR (Cheson 2007-criteria), Progression free survival (Lugano), Overall survival, CR-Rate (Lugano), Best response (Lugano), Quality of Life measured with EORTC QLQ C30 and NHL-HG29 (global QoL, physical functioning, fatigue), ORR in separate GCB vs. non GCB-analysis is planned, Safety Endpoints: Safety and tolerability as measured by rate of AE, SAE compared between Arm A and B

Source: https://euclinicaltrials.eu/ctis-public/view/2024-514775-17-00